EU clinical trial 2024-517101-87-00: A Multi-center, Double-Blind, Randomized, Two-Arm, Parallel-Group, Placebo Controlled Study to Assess the Efficacy and Safety of ELGN-2112 on Intestinal Malabsorption in Preterm Infants
Protocol code: FIT-PIV
Sponsor: Elgan Pharma Ltd. (Pharmaceutical company). Phase: Therapeutic confirmatory (Phase III). Countries: Austria (ongoing, recruiting), Netherlands (ongoing, recruiting), Spain (ongoing, recruiting), Sweden (ongoing, recruiting), France (ongoing, recruiting), Italy (ongoing, recruiting).
Therapeutic area(s): Diseases [C] - Congenital, Hereditary, and Neonatal Diseases and Abnormalities [C16]
Gender: Female, Male. Age: 0-17 years. Enrolment: 295.
Status: Ongoing, recruiting. Start date (EU): 2025-05-26. Decision date: 2024-10-25. Results received: No. Last updated: 2026-04-14.
Decision dates by country: FR: 2024-10-28, NL: 2024-10-25, ES: 2024-10-28, AT: 2024-10-30, SE: 2024-10-28, IT: 2025-09-25

Condition(s): Intestinal Malabsorption
Product: Powder for reconstitution for enteral administration

Primary endpoint: Number of days from treatment initiation to achieve full enteral feeding*, which is defined as the number of days to achieve enteral feeding of at least 150 ml/kg/day for three consecutive days during the treatment period *Defined as first day of reaching three consecutive days of EN feeds ≥150 ml/kg/day
Endpoint(s): The number of days from treatment initiation to PN wean-off during the treatment period, Incidence of severe NEC (modified Bell’s stage ≥2a) by 40 weeks post-menstrual age (PMA) or discharge home, whichever is earlier, in infants born at 26+0-28+6 weeks GA (FIT-PIV study) and infants born less than 26+0 weeks GA and IUGR infants born at 26+0-31+6 weeks GA (FIT-05 study) as assessed by central blinded reviewers and classified according to the “Modified Bell’s Staging Criteria for NEC” (Walsh-1986)., Incidence of severe NEC (modified Bell’s stage ≥2a) by 40 weeks PMA or discharge home, whichever is earlier, in infants born at 26+0-28+6 weeks GA as assessed by central blinded reviewers and classified according to the “Modified Bell’s Staging Criteria for NEC” (Walsh-1986)., The number of days from treatment initiation to discharge from primary hospital, Distribution of severity of NEC by 40 weeks PMA or discharge home, whichever is earlier, in infants born at 26+0-28+6 weeks GA (FIT-PIV study) and infants born less than 26+0 weeks GA and IUGR infants born at 26+0-31+6 weeks GA (FIT-05 study) as assessed by central blinded reviewers and classified according to the “Modified Bell’s Staging Criteria for NEC” (Walsh-1986) - pooled analysis, Distribution of severity of NEC by 40 weeks PMA or discharge home, whichever is earlier, according to modified Bell’s staging in infants born at 26+0-28+6 weeks GA as assessed by central blinded reviewers and classified according to the “Modified Bell’s Staging Criteria for NEC” (Walsh-1986)., Incidence of severe NEC by 40 weeks PMA or discharge home, whichever is earlier, in the entire study population as assessed by central blinded reviewers and classified according to the “Modified Bell’s Staging Criteria for NEC” (Walsh-1986)., Distribution of severity of NEC by 40 weeks PMA or discharge home, whichever is earlier, in the entire study population as assessed by central blinded reviewers and classified according to the “Modified Bell’s Staging Criteria for NEC” (Walsh-1986)., Percentage of infants reaching FEF for three consecutive days within 6, 8, and 10 days from treatment initiation, The number of days from treatment initiation to the first day the infant achieves EN volume of 120 ml/kg/day for three consecutive days during the treatment period, Percentage of infants weaned off PN within 4, 6, and 8 days from treatment initiation, Neonatal anthropometrics measurements during the treatment period and up to 3 months CA., Percentage of EN and PN over total nutrition during the treatment period, Incidence of late onset sepsis (onset ≥72 hours after birth) by 40 weeks PMA or discharge home, whichever is earlier. Will be defined as either: a) culture proven late onset sepsis, OR b) clinically suspected culture negative late onset sepsis, Incidence of at least one of the adverse events of relevance by 40 weeks PMA or discharge home, whichever is earlier: • severe NEC (modified Bell’s stage ≥2a); • late-onset sepsis • death., The number of days from treatment initiation to discharge to home, Incidence and severity of ROP up to 3 months CA according to the International Classification of Retinopathy of Prematurity (ICROP3), Adverse Events (AEs) and Adverse Drug Reaction (ADRs); Blood glucose; Blood chemistry and haematology; Vital signs, Major morbidities (including cerebral palsy, severe vision and hearing loss and hospitalisation) at 6, 12 and 24 months CA; Anthropometrics measurements at 6, 12 and 24 months CA; Neurodevelopmental assessment at 24 months CA

Source: https://euclinicaltrials.eu/ctis-public/view/2024-517101-87-00